EU clinical trial 2023-506238-61-00: A Phase 3, Randomized, Crossover, Open-Label, Active-Controlled Study of Sepiapterin versus Sapropterin in Participants With Phenylketonuria ≥2 years of Age
Protocol code: PTC923-PKU-301
Sponsor: PTC Therapeutics Inc. (Pharmaceutical company). Phase: Therapeutic confirmatory (Phase III). Countries: Denmark (ended), Spain (ended), Italy (ended), France (ended), Germany (ended), Slovenia (ended), Czechia (ended), Poland (ended), Netherlands (ended).
Therapeutic area(s): Phenomena and Processes [G] - Metabolism [G03]
Gender: Female, Male. Age: 0-17 years, 18-64 years, 65+ years. Enrolment: 119.
Status: Ended. Start date (EU): 2024-05-10. End date (EU): 2025-01-27. End date: 2025-03-13. Decision date: 2024-04-15. Results received: Yes. Last updated: 2025-12-22.
Decision dates by country: CZ: 2024-04-16, ES: 2024-04-16, DE: 2024-04-17, PL: 2024-04-16, FR: 2024-04-17, SI: 2024-04-15, IT: 2024-04-16, DK: 2024-04-15, NL: 2024-07-22

Condition(s): Phenylketonuria
Product: PTC923, Kuvan 100 mg soluble tablets, PTC923

Primary endpoint: Mean change in blood Phe levels from baseline to Weeks 3 and 4 of each treatment period (the average of the last 2 weeks of each treatment period) in Part 2
Endpoint(s): Proportion of participants with baseline blood Phe levels ≥600 µmol/L who achieve Phe levels <600 µmol/L after each treatment period in Part 2, Proportion of participants reaching blood Phe <360 µmol/L after each treatment period in Part 2, AEs, physical examinations, vital sign assessments, 12-lead ECGs, and routine clinical laboratory assessments

Source: https://euclinicaltrials.eu/ctis-public/view/2023-506238-61-00